EU clinical trial 2023-509766-37-00: A Multicenter, Randomized, Double-blind Trial to Demonstrate Similar Efficacy, Safety, and Immunogenicity of FYB206 (Keytruda Biosimilar Candidate) in Comparison to Keytruda (Pembrolizumab) as an Add-on to Chemotherapy in Treatment-naïve Patients with Metastatic Non-squamous Non-small Cell Lung Cancer (LOTUS)
Protocol code: FYB206-C3-02
Sponsor: Formycon AG (Pharmaceutical company). Phase: Therapeutic confirmatory (Phase III). Countries: Romania (ended), Bulgaria (ended), Poland (ended).
Therapeutic area(s): Diseases [C] - Neoplasms [C04]; Diseases [C] - Respiratory Tract Diseases [C08]
Gender: Female, Male. Age: 18-64 years, 65+ years. Enrolment: 81.
Status: Ended. End date (EU): 2025-02-18. End date: 2025-02-19. Decision date: 2024-08-26. Results received: Yes. Last updated: 2024-08-26.
Decision dates by country: BG: 2024-08-26, RO: 2024-08-26, PL: 2024-08-26

Condition(s): NSCLC
Product: KEYTRUDA 25 mg/mL concentrate for solution for infusion, FYB206, KEYTRUDA 25 mg/mL concentrate for solution for infusion, KEYTRUDA 25 mg/mL concentrate for solution for infusion, KEYTRUDA 25 mg/mL concentrate for solution for infusion

Primary endpoint: Measured as the proportion of participants whose cancer resolves completely or partially after approximately 9 months (40 weeks) from the start of treatment
Endpoint(s): Measured as: proportion of participants (1) whose cancer resolves completely or partially at prespecified timepoints during the first year, (2) without disease progression* or death after one year. (3) alive after one year, (4) time for cancer to resolve completely or partially, (5) time from cancer resolving completely or partially until disease progression., *Disease progression means significant tumor growth compared to the previous measurement. Identify and monitor the side effects, vital signs, oxygen levels, laboratory test results, and other health indicators that change during the study during the first year of treatment., Number of participants who develop antibodies against the treatments when assessed at pre-decided timepoints. ‘Antibodies’ helps protect the body against foreign matter, such as bacteria and viruses or allergens. Sometimes, the body identifies some drugs or treatments as foreign matter and makes antibodies to fight them., Measured as the lowest amounts of the drug 1 hour before the next dose was given, at various points during the first year of treatment.

Source: https://euclinicaltrials.eu/ctis-public/view/2023-509766-37-00